EU clinical trial 2023-508536-64-00: A Multi-arm, Open-label Phase I/IIa Study to Assess the Safety, Tolerability, Pharmacokinetics, Pharmacodynamics and Preliminary Efficacy of AZD5305 in Combination with New Hormonal Agents in Patients with Metastatic Prostate Cancer (PETRANHA)
Protocol code: D9720C00003
Sponsor: AstraZeneca AB (Pharmaceutical company). Phase: Phase I and Phase II (Integrated)- Other. Countries: Italy (ongoing, recruitment ended).
Therapeutic area(s): Diseases [C] - Neoplasms [C04]
Gender: Male. Age: 18-64 years, 65+ years. Enrolment: 50.
Status: Ongoing, recruitment ended. Start date (EU): 2022-05-17. Decision date: 2024-02-28. Results received: No. Last updated: 2026-08-05.

Condition(s): Metastatic Prostate Cancer
Product: Prednisone Mylan Pharma 5 mg compresse, Erleada 60 mg film-coated tablets, Xtandi - 40 mg soft capsules, Saruparib, Saruparib, NUBEQA 300 mg film-coated tablets, ZYTIGA 500 mg film-coated tablets, Saruparib

Primary endpoint: AZD5305 in combination with NHA: Number of participants with adverse events/ serious adverse events, AZD5305 in combination with NHA: Number of participants with Dose Limiting Toxicities (DLTs) [Part A], AZD5305 in combination with NHA: Changes from baseline in laboratory findings, physical examination, ECOG performance status, ECGs, and vital signs
Endpoint(s): PK Parameters: (AZD5305 monotherapy): Area Under the concentration Curve (AUC) of AZD5305, PK Parameters: (AZD5305 monotherapy): Maximum plasma concentration (Cmax) of AZD5305, PK Parameters: (AZD5305 monotherapy): Time to maximum concentration (tmax) of AZD5305;, PK Parameters: (AZD5305 in combination with NHA): AUC of AZD5305, PK Parameters: (AZD5305 in combination with NHA): Cmax of AZD5305, PK Parameters: (AZD5305 in combination with NHA): tmax of AZD5305;, Efficacy parameters: Objective response rate (ORR), Efficacy parameters: Duration of response (DoR), Efficacy parameters: Time to response (TTR), Efficacy parameters: Radiographic progression-free survival (rPFS), Efficacy parameters: Percentage change in target lesion size, Efficacy parameters: Proportion of participants with ≥ 50% PSA decrease, Efficacy parameters: Proportion of participants with ≥ 90% PSA decrease, Efficacy parameters: Proportion of patients with undetectable PSA (< 0.2 ng/mL) [Part B], Efficacy parameters: PSA progression free survival, Efficacy parameters: Homologous recombination repair gene mutation (HRRRm) (including BRCA1/2) and their relationship with clinical response [Part B], [Part A] PK parameters of Enzalutamide and Apalutamide in combination with AZD5305: AUC of enzalutamide and apalutamide, [Part A] PK parameters of Enzalutamide and Apalutamide in combination with AZD5305: Cmax of enzalutamide and apalutamide, [Part A] PK parameters of Enzalutamide and Apalutamide in combination with AZD5305: tmax of enzalutamide and apalutamide

Source: https://euclinicaltrials.eu/ctis-public/view/2023-508536-64-00